EU clinical trial 2024-520237-77-00: TAILORED-PROM: TAILORED therapeutic regime in patients with preterm Premature Rupture Of Membranes to prolong pregnancy, improve maternal and neonatal outcomes, and reduce antibiotic burden
Protocol code: TAILORED-PROM
Sponsor: Vseobecna Fakultni Nemocnice V Praze (Hospital/Clinic/Other health care facility). Phase: Therapeutic confirmatory (Phase III). Countries: Czechia (ongoing, recruiting).
Therapeutic area(s): Diseases [C] - Female Urogenital Diseases and Pregnancy Complications [C13]
Gender: Female. Age: In utero, 18-64 years. Enrolment: 138.
Status: Ongoing, recruiting. Start date (EU): 2025-06-24. Decision date: 2025-04-17. Results received: No. Last updated: 2025-10-07.

Condition(s): Preterm premature rupture of membrance in pregnancy.
Product: CLARITHROMYCIN, DEXAMETHASONE, AMPICILLIN AND BETA-LACTAMASE INHIBITOR, MAGNESIUM SULFATE, BENZYLPENICILLIN, GENTAMICIN

Primary endpoint: The primary endpoint of the study is the latency of pregnancy of more than 7 days from premature rupture of membranes to delivery.
Endpoint(s): Latency to birth, Incidence of chorioamnionitis and funisitis, Short-term adverse maternal outcomes, Short-term neonatal outcomes, Microbiome in mother and newborn - optional outcome

Source: https://euclinicaltrials.eu/ctis-public/view/2024-520237-77-00